EU clinical trial 2024-513988-70-00: A TWO-PART ABSOLUTE BIOAVAILABILITY STUDY DESIGNED TO EVALUATE THE PHARMACOKINETIC PROFILE OF VELUSETRAG FOLLOWING SINGLE-DOSE ADMINISTRATION OF INTRAVENOUS AND ORAL CAPSULE FORMULATIONS IN HEALTHY MALE AND FEMALE SUBJECTS
Protocol code: VE-CIP1002/2021
Sponsor: Alfasigma S.p.A. (Pharmaceutical company). Phase: Human Pharmacology (Phase I)- Other. Countries: Netherlands (ended).
Therapeutic area(s): Diseases [C] - Digestive System Diseases [C06]
Gender: Female, Male. Age: 18-64 years. Enrolment: 20.
Status: Ended. Start date (EU): 2024-10-07. End date (EU): 2025-02-21. Decision date: 2024-09-10. Results received: No. Last updated: 2024-12-12.

Condition(s): chronic intestinal pseudo-obstruction (CIPO)

Source: https://euclinicaltrials.eu/ctis-public/view/2024-513988-70-00